EU clinical trial 2025-524746-96-00: Phase 1 Single Dose Study of JADE201 in Participants with Rheumatoid Arthritis
Protocol code: JADE201-01
Sponsor: Jade Biosciences Inc. (Pharmaceutical company). Phase: Human Pharmacology (Phase I)- First administration to humans. Countries: Romania (authorised, recruiting), Bulgaria (authorised, recruiting), Germany (authorised, recruiting).
Therapeutic area(s): Diseases [C] - Immune System Diseases [C20]
Gender: Female, Male. Age: 18-64 years, 65+ years. Enrolment: 24.
Status: Authorised, recruiting. Start date (EU): 2026-07-15. Decision date: 2026-06-25. Results received: No. Last updated: 2026-06-29.
Decision dates by country: BG: 2026-06-26, DE: 2026-06-25, RO: 2026-06-29

Condition(s): Rheumatoid Arthritis

Source: https://euclinicaltrials.eu/ctis-public/view/2025-524746-96-00